EU clinical trial 2024-511018-18-00: Prospective comparative randomized study of procedural sedation during TAVR (Transcatheter Aortic Valve Replacement)
Sponsor: Azienda Socio Sanitaria Territoriale Ovest Milanese (Hospital/Clinic/Other health care facility). Phase: Therapeutic confirmatory (Phase III). Countries: Italy (ongoing, recruiting).
Therapeutic area(s): Health Care [N] - Health Care Quality, Access, and Evaluation [N05]; Diseases [C] - Cardiovascular Diseases [C14]; Analytical, Diagnostic and Therapeutic Techniques and Equipment [E] - Anesthesia and Analgesia [E03]
Gender: Female, Male. Age: 18-64 years, 65+ years. Enrolment: 1.
Status: Ongoing, recruiting. Start date (EU): 2024-08-09. Decision date: 2024-07-01. Results received: No. Last updated: 2024-07-01.

Condition(s): patients with aortic stenosis underwent transcatheter aortic valve replacement
Product: Remifentanil Mylan 1 mg, poeder voor concentraat voor oplossing voor injectie of infusie, Dexmedetomidina Ever Pharma 100 microgrammi/ml concentrato per soluzione per infusione, Propofol Kabi 10 mg/ml emulsione iniettabile o per infusione, KETAMINA MOLTENI 50 mg/ml soluzione iniettabile

Primary endpoint: Incidence of respiratory acidosis: Defined as pH<7.35 and an increase in PaCO2 compared to baseline, measured through serial arterial blood gas analysis during the procedure., Incidence of emergence delirium: Assessed through the administration of the CAM-ICU (Confusion Assessment Method for the Intensive Care Unit) within the first 24 hours following the end of the procedure.
Endpoint(s): The assessment of sedation effectiveness includes: - Time to achieve the desired sedation target (from the start of sedation to reaching a Richmond Agitation Sedation Scale of -2/-3). - Time to meet discharge criteria from the operating room (from sedation cessation to achieving an Aldrete's scoring system score >9). - Incidence of agitation episodes (RASS > +1). - Intraprocedural need to deviate from the established protocol beyond the therapeutic ranges indicated., The assessment of the incidence of intra-procedural adverse events includes: - Incidence of respiratory events (desaturation, need for supplemental oxygen, loss of respiratory drive, need for mask ventilation, respiratory acidosis with pH<7.35 and an increase in PaCO2 compared to baseline). - Incidence of hemodynamic events (hypotension, bradycardia, need for vasopressor support)., The evaluation of post-operative adverse events includes: - Total duration of hospitalization. - Incidence of post-operative cognitive decline (changes in Mini Mental State postoperative compared to baseline).

Source: https://euclinicaltrials.eu/ctis-public/view/2024-511018-18-00